EU clinical trial 2025-523766-25-00: A Phase 3, Randomized, Double-Blind, Placebo-Controlled Program to Evaluate the Efficacy and Safety of MK-7240 in Participants with Moderately to Severely Active Ulcerative Colitis
Protocol code: MK-7240-001
Sponsor: Merck Sharp & Dohme LLC (Pharmaceutical company). Phase: Therapeutic confirmatory (Phase III). Countries: Slovakia (ongoing, recruitment ended), Poland (ongoing, recruitment ended), Netherlands (ongoing, recruitment ended), Spain (ongoing, recruitment ended), Romania (ongoing, recruitment ended), Portugal (ongoing, recruitment ended), Italy (ongoing, recruitment ended), Hungary (ongoing, recruitment ended), Greece (ongoing, recruitment ended), Czechia (ongoing, recruitment ended), Croatia (ongoing, recruitment ended), Bulgaria (ongoing, recruitment ended), Austria (ongoing, recruitment ended), Germany (ongoing, recruitment ended), France (ongoing, recruitment ended), Belgium (ended), Finland (ongoing, recruitment ended), Norway (ongoing, recruitment ended), Lithuania (ongoing, recruitment ended).
Therapeutic area(s): Diseases [C] - Digestive System Diseases [C06]
Gender: Female, Male. Age: 18-64 years, 65+ years. Enrolment: 476.
Decision date: 2024-06-07. Results received: No. Last updated: 2026-02-24.
Decision dates by country: BE: 2024-07-30, HR: 2024-04-26, BG: 2024-04-29, NO: 2024-07-19, RO: 2024-04-29, HU: 2024-04-24, PL: 2024-04-29, ES: 2024-04-26, IT: 2024-04-24, GR: 2024-04-29, NL: 2024-04-25, LT: 2024-11-20, FI: 2024-08-09, AT: 2024-04-29, CZ: 2024-04-23, SK: 2024-06-07, FR: 2024-08-20, PT: 2024-06-12, DE: 2024-06-28

Condition(s): Ulcerative colitis
Product: tulisokibart, tulisokibart, Placebo to MK-7240

Primary endpoint: Study 1: Percentage of Participants Achieving Clinical Remission Per Modified Mayo Score (MMS) at Week 12, Study 1: Percentage of Participants Achieving Clinical Remission Per MMS at Week 52
Endpoint(s): Study 1: Percentage of Participants With One or More Adverse Events (AEs), Study 1: Percentage of Participants Who Discontinued Study Intervention Due to an AE, Study 1: Percentage of Participants With Endoscopic Improvement at Week 12, Study 1: Percentage of Participants Achieving Clinical Response Per MMS at Week 12, Study 1: Percentage of Participants Achieving Histologic-Endoscopic Mucosal Improvement (HEMI) at Week 12, Study 1: Percentage of Participants Achieving Clinical Remission Per partial MMS (pMMS) at Week 12, Study 1: Percentage of Participants Achieving Clinical Response Per pMMS at Week 2, Study 1: Percentage of Participants With Endoscopic Remission at Week 12, Study 1: Percentage of Participants Reporting No Bowel Urgency at Week 12, Study 1: Percentage of Participants Reporting No Abdominal Pain at Week 12, Study 1: Percentage of Participants Achieving Inflammatory Bowel Disease Questionnaire (IBDQ) Remission at Week 12, Study 1: Change from Baseline in Functional Assessment of Chronic Illness Therapy - Fatigue (FACIT-Fatigue) Score at Week 12, Study 1: Percentage of Diagnostic Assay Positive (Dx+) Participants Achieving Clinical Remission Per MMS at Week 12, Study 1: Percentage of Dx+ Participants With Endoscopic Improvement at Week 12, Study 1: Percentage of Participants Achieving Histologic-Endoscopic Remission (HER) at Week 12, Study 1: Percentage of Participants with Endoscopic Improvement at Week 52, Study 1: Percentage of Participants Achieving Corticosteroid-Free Clinical Remission Per MMS at Week 52, Study 1: Percentage of Participants Achieving HEMI at Week 52, Study 1: Percentage of Participants Achieving Clinical Remission Per pMMS at Week 52, Study 1: Percentage of Participants Achieving Sustained Clinical Remission Per MMS at Both Week 12 and Week 52, Study 1: Percentage of Participants Reporting No Bowel Urgency at Week 52, Study 1: Percentage of Participants Reporting No Abdominal Pain at Week 52, Study 1: Percentage of Participants With Endoscopic Remission at Week 52, Study 1: Percentage of Participants with Sustained Endoscopic Improvement at Both Week 12 and Week 52, Study 1: Percentage of Participants Achieving HER at Week 52, Study 1: Percentage of Participants Achieving IBDQ Remission at Week 52, Study 1: Change from Baseline in FACIT-Fatigue Score at Week 52, Study 1: Percentage of Dx+ Participants Achieving Clinical Remission Per MMS at Week 52, Study 1: Percentage of Dx+ Participants With Endoscopic Improvement at Week 52

Source: https://euclinicaltrials.eu/ctis-public/view/2025-523766-25-00